EU clinical trial 2023-510564-12-00: Perioperative Inhaled Therapy in Carcinological Thoracic Surgery in patients at high risk of postoperative pulmonary complications
Protocol code: PI2023_843_0151
Sponsor: Centre Hospitalier Universitaire Amiens Picardie (Hospital/Clinic/Other health care facility). Phase: Therapeutic confirmatory (Phase III). Countries: France (ongoing, recruiting).
Therapeutic area(s): Diseases [C] - Respiratory Tract Diseases [C08]
Gender: Female, Male. Age: 18-64 years. Enrolment: 266.
Status: Ongoing, recruiting. Start date (EU): 2025-08-14. Decision date: 2024-10-15. Results received: No. Last updated: 2026-05-06.

Condition(s): postoperative pulmonary complications
Product: FORMOTEROL

Primary endpoint: postoperative pulmonary complications (PPC) at D7 post thoracic surgery
Endpoint(s): Post-operative pulmonary complications at D7 and interaction between group with/without bronchodilator and ARISCAT score, Post-operative pulmonary complications at D7 and interaction between the group with/without bronchodilator and the presence or absence of COPD., Post-operative pulmonary complications at D7 and interaction between the bronchodilator/no bronchodilator group and long-term inhaled anticholinergic therapy, Post-operative pulmonary complications at D28 (assessed as for primary endpoint), Pulmonary function by spirometry on D7 (or day of discharge if earlier) and D28 post-op (measured with the Spirolab® Spirometer validated for bed-side measurements: [including: forced expiratory volume in 1 second (FEV1), forced vital capacity (FVC), Tiffeneau ratio = FEV1/FVCx 100, peak expiratory flow (PEF)] etc.)., Cardiovascular complications (cardiac arrhythmia, acute myocardial infarction according to the 4th universal definition, ischemic or hemorrhagic stroke) at D28 post-op., Postoperative survival status, Quality of life assessed at D7 (or discharge), D28 and 6 months post-operatively using the standardized questionnaire [EuroQol-5D (EQ-5D)] via remote telephone cal, - Potential treatment-related adverse events (investigated daily in hospital): o Flushing o Dry mouth, dysgeusia o Headaches, tremors o Palpitations, atrial fibrillation, extrasystoles, tachycardia (> 100/min over 24h), prolonged QTc (> 450 ms in men and 470 ms in women) o Hypokalemia (< 3.5mmol/l) o Hyperglycemia (> 10 mmol/L)

Source: https://euclinicaltrials.eu/ctis-public/view/2023-510564-12-00